EU clinical trial 2024-512625-86-00: A randomised phase II trial evaluating the efficacy of a nivolumab monotherapy lead in “window” or commencement of nivolumab concurrently with paclitaxel and carboplatin as neoadjuvant therapy in early stage triple negative breast cancers
Protocol code: BCT 1902
Sponsor: ANZ Breast Cancer Trials Group Limited (Laboratory/Research/Testing facility). Phase: Therapeutic exploratory (Phase II). Countries: Italy (ended).
Therapeutic area(s): Diseases [C] - Neoplasms [C04]
Gender: Female, Male. Age: 18-64 years, 65+ years. Enrolment: 1.
Status: Ended. Start date (EU): 2022-01-27. End date (EU): 2025-07-18. Decision date: 2024-07-22. Results received: No. Last updated: 2025-07-03.

Condition(s): Early stage triple negative breast cancer
Product: OPDIVO 10 mg/mL concentrate for solution for infusion.

Primary endpoint: Pathological complete response (pCR breast and nodes) as defined by ypT0/Tis/ypN0
Endpoint(s): Pathological complete response (pCR as defined by ypT0/Tis/ypN0) in the higher TIL subgroup (%TIL on baseline H&E 30% or more), Pathological complete response (pCR as defined by ypT0/Tis/ypN0) in the PD-L1 positive subgroup (defined as 1% or more immune cell staining using the Ventana SP142 assay), Pathological complete response (pCR) in breast (ypT0/Tis), Residual cancer burden (RCB)0/1, Tumour response by WHO Criteria, Ki67 proliferation marker changes between baseline and surgery, Safety and tolerability as documented according to NCI-CTCAE V5.0, Event free survival and overall survival over a 3-year period

Source: https://euclinicaltrials.eu/ctis-public/view/2024-512625-86-00